EU clinical trial 2024-517147-31-00: A Phase I/II Randomized Multi-Cohort Study to Evaluate the Safety, Tolerability, Pharmacokinetics and Clinical Activity of GSK5733584 in Combination with Anti-Cancer Agents in Participants with Advanced Solid Tumors.
Protocol code: 223559
Sponsor: Glaxosmithkline Research & Development Limited (Pharmaceutical company). Phase: Phase I and Phase II (Integrated)- Other. Countries: Greece (ongoing, recruiting), Spain (ongoing, recruiting), Finland (ongoing, recruiting), Denmark (ongoing, recruiting), Germany (ongoing, recruiting), Netherlands (ongoing, recruiting), Poland (ongoing, recruiting), Norway (ongoing, recruiting), Italy (ongoing, recruiting), France (ongoing, recruiting), Sweden (ongoing, recruiting), Belgium (ongoing, recruiting).
Therapeutic area(s): Diseases [C] - Neoplasms [C04]
Gender: Female, Male. Age: 18-64 years, 65+ years. Enrolment: 217.
Status: Ongoing, recruiting. Start date (EU): 2025-05-23. Decision date: 2025-05-02. Results received: No. Last updated: 2026-04-28.
Decision dates by country: PL: 2025-05-05, ES: 2025-05-06, BE: 2025-05-07, NL: 2025-05-05, DE: 2025-05-06, IT: 2025-05-06, SE: 2025-05-05, FR: 2025-05-05, DK: 2025-05-05, FI: 2025-05-05, GR: 2025-05-02, NO: 2025-05-07

Condition(s): Tumours, Gynecological
Product: Carboplatino Hikma 10 mg/ml soluzione per infusione, Avastin 25 mg/ml concentrate for solution for infusion., Cisplatino Accord Healthcare Italia 1 mg/ml concentrato per soluzione per infusione, JEMPERLI 500 mg concentrate for solution for infusion

Primary endpoint: Part A (Dose Exploration) •Percentage of participants with dose limiting toxicities (DLTs) per dose level •Frequency and severity of AEs, imAEs (dostarlimab Modules), AESIs and SAEs per dose level., Part B Dose Expansion •Clinical activity measured as confirmed ORR assessed by investigator according to RECIST 1.1
Endpoint(s): Part A (Dose Exploration) •Clinical activity measured as confirmed ORR, DoR, and PFS by dose level assessed by investigator according to RECIST v1.1., Part A (Dose Exploration) PK parameters (e.g., Cmax, tmax, Ctrough, AUC) for GSK5733584 (conjugated antibody and payload) as data permit., Part A (Dose Exploration) •Incidence of ADA, nAb and ADA titers., Part A (Dose Exploration) •Changes in vital signs, laboratory measures, ECGs, and Eastern Cooperative Oncology Group Performance Status (ECOG PS) score., Part B Dose Expansion Clinical activity measured as DoR, PFS assessed by investigator according to RECIST 1.1 and OS, Part B Dose Expansion PK parameters (e.g., Cmax, tmax, Ctrough, AUC) for GSK5733584 (conjugated antibody and payload), as data permit, Part B Dose Expansion •Incidence of ADA, nAb and ADA titers., Part B Dose Expansion •Frequency and severity of AEs, imAEs (dostarlimab Modules), AESIs and SAEs per dose level •Changes in vital signs, laboratory measures, ECGs, and ECOG PS score.

Source: https://euclinicaltrials.eu/ctis-public/view/2024-517147-31-00